EU clinical trial 2025-522963-14-00: An Exploratory, First-in-Human, study to investigate the safety and preliminary efficacy of InvivoLPrint-U-Therapy, a combination of an advanced therapy medicinal product (ATMP) of expanded autologous urothelial cells with an in vivo bioprinter for administration during orthotopic neobladder surgery
Protocol code: U-LaserPrint-1
Sponsor: Phosprint S.A. (Pharmaceutical company). Phase: Human Pharmacology (Phase I)- First administration to humans. Countries: Greece (ongoing, recruiting).
Therapeutic area(s): Analytical,Diagnostic,Therapeutic Techniques and Equipment [E]-Surgical Procedures, Operative [E04]; Diseases [C] - Neoplasms [C04]
Gender: Female, Male. Age: 18-64 years, 65+ years. Enrolment: 6.
Status: Ongoing, recruiting. Start date (EU): 2026-05-09. Decision date: 2025-12-17. Results received: No. Last updated: 2026-06-30.

Condition(s): Μuscle-invasive bladder cancer (MIBC) patients, eligible for neobladder reconstruction following radical cystectomy
Product: aUroCell-Tx

Primary endpoint: Proportion of patients with fatal event (death), Proportion of patients with neobladder rejection, Proportion of patients for whom revision surgery was required, Proportion of patients who were free from the composite endpoint of death, neobladder rejection and need for revision surgery, Peri-and post-surgical complications/SAEs
Endpoint(s): 1.1 Device success, defined as successful delivery of the ATMP onto the neobladder according to the study protocol, 1.2 Device adverse effects and deficiencies, 1.3 Ease of use of the bioprinter, 2.1 Urinary continence, 2.2 Absence of mucus, 2.3 Metabolic imbalances and blood acidosis (blood), 2.4 Extent of coverage of the denuded intestinal tissue, 2.5 Histological profile of regenerated urothelium, 2.6 Change from baseline in total score and in each specific domain of the Health-related quality of life (HRQoL) questionnaire EORTC QLQ-C30

Source: https://euclinicaltrials.eu/ctis-public/view/2025-522963-14-00